EU clinical trial 2022-500922-13-00: Thiamine against chronic rheumatoid arthritis fatigue
Sponsor: Aarhus University Hospital (Hospital/Clinic/Other health care facility). Phase: Phase II and Phase III (Integrated). Countries: Denmark (ended).
Therapeutic area(s): Diseases [C] - Musculoskeletal Diseases [C05]; Diseases [C] - Immune System Diseases [C20]
Gender: Female, Male. Age: 18-64 years, 65+ years. Enrolment: 40.
Status: Ended. Start date (EU): 2023-02-16. End date (EU): 2023-08-30. Decision date: 2022-10-20. Results received: Yes. Last updated: 2023-03-03.

Condition(s): Rheumatoid Arthritis
Product: THIAMINE (VIT B1), Placebo (Lactose monohydrate, potato starch, gelatin A, water purified, magnesium stearate MF 2V, Talc.) 12 mm, white, round, plane tablets with slanted edges, scoreline on one side. Identical formulation to the SAD tablet, but without the active ingredient.

Primary endpoint: A change in fatigue level immediately after 4 weeks of high-dose thiamine treatment. The minimal clinically important difference (MCID) is a decrease of 7,43 points or an increase of 2,58 points on the BRAF-MDQ total fatigue score.
Endpoint(s): A change in the patients’ quality of life at week 4, 8 and 12. Difference in EQ-5D score, MCID of 0,04., A change in blood lactate concentration at week 4, 8 and 12., Side effects to the treatment.

Source: https://euclinicaltrials.eu/ctis-public/view/2022-500922-13-00